EU clinical trial 2024-512152-38-00: Tumour heterogeneity studies based on dedicated breast PET using proliferation radiotracers: early detection of the treatment response.
Protocol code: MIBIOTIMI
Sponsor: Fundacion Instituto De Investigacion Sanitaria De Santiago De Compostela (Patient organisation/association). Phase: Phase I and Phase II (Integrated)- Other. Countries: Spain (authorised, recruitment pending).
Therapeutic area(s): Diseases [C] - Neoplasms [C04]
Gender: Female. Age: 18-64 years, 65+ years. Enrolment: 100.
Status: Authorised, recruitment pending. Decision date: 2024-11-15. Results received: No. Last updated: 2024-11-15.

Condition(s): Breast cancer

Source: https://euclinicaltrials.eu/ctis-public/view/2024-512152-38-00